EU clinical trial 2025-523109-14-00: A prospective, open-label, non-randomized, multicentre trial to assess the safety and PD of Cangrelor as procedural platelet inhibitor in paediatric subjects from birth to <18 years of age undergoing diagnostic and/or therapeutic percutaneous vascular procedures for management of congenital heart disease
Protocol code: CLI-06727AA1-03
Sponsor: Chiesi Farmaceutici S.p.A. (Pharmaceutical company). Phase: Therapeutic confirmatory (Phase III). Countries: Netherlands (authorised, recruitment pending), Germany (authorised, recruitment pending), Portugal (authorised, recruitment pending), Austria (authorised, recruitment pending).
Therapeutic area(s): Diseases [C] - Cardiovascular Diseases [C14]
Gender: Female, Male. Age: 0-17 years. Enrolment: 48.
Status: Authorised, recruitment pending. Decision date: 2026-06-08. Results received: No. Last updated: 2026-07-23.
Decision dates by country: NL: 2026-06-11, PT: 2026-06-09, DE: 2026-06-08, AT: 2026-06-08

Condition(s): Congenital Heart Disease
Product: Kengrexal 50 mg powder for concentrate for solution for injection/infusion

Primary endpoint: Percentage of subjects with major, clinically relevant non-major (CRNM) or minor bleeding (as defined by the Scientific and Standardisation Subcommittee [SSC] on Paediatric and Neonatal Thrombosis and Haemostasis from the International Society on Thrombosis and Haemostasis [ISTH]) occurring within 72 hours after the start of Cangrelor infusion, Percentage of subjects requiring hemoderivative transfusion related to Cangrelor infusion, Percentage of subjects with new onset of dyspnoea, wheezing or respiratory distress, or experiencing worsening of any pre-treatment dyspnoea, wheezing or respiratory distress after the start of Cangrelor infusion, Vital signs (including HR, SBP and DBP), Laboratory parameters (including haematology, blood chemistry and urinalysis), Percentage of subjects with an increase in creatinine >2 times the pre-infusion value, Percentage of subjects experiencing an AE of decrease in urine output considered related to Cangrelor, Treatment-emergent adverse events (TEAEs), adverse drug reactions (ADRs), serious adverse events, severe TEAEs and TEAEs leading to study discontinuation

Source: https://euclinicaltrials.eu/ctis-public/view/2025-523109-14-00